EU clinical trial 2024-512590-27-00: Single arm phase II study of the efficacy and safety of the combination of Trastuzumab plus TUCAtinib plus viNorelbine in patients with HER2-positive non-resectable locally advanced or metastatic breast cancer “TrasTUCAN Study”
Protocol code: GEICAM/2020-08
Sponsor: Fundacion Grupo Espanol De Investigacion En Cancer De Mama (Patient organisation/association). Phase: Phase I and Phase II (Integrated)- Other. Countries: Spain (ended).
Therapeutic area(s): Diseases [C] - Neoplasms [C04]
Gender: Female, Male. Age: 18-64 years, 65+ years. Enrolment: 49.
Status: Ended. Start date (EU): 2023-03-08. End date (EU): 2025-05-30. Decision date: 2024-06-19. Results received: Yes. Last updated: 2024-06-19.

Condition(s): Non-resectable locally advanced or metastatic HER2-positive breast cancer
Product: TUKYSA 50 mg film-coated tablets, TUKYSA 150 mg film-coated tablets

Primary endpoint: Objective response rate (ORR) defined as the rate of complete response (CR) plus partial response (PR) based on the investigator’s assessment using the response evaluation criteria for solid tumors (RECIST) version 1.1., out of the patients who received at least 1 dose of treatment.
Endpoint(s): ORR (already defined) in patients with brain metastasis at baseline., Other efficacy endpoints in all patients and patients with brain metastasis at baseline: -Progression free survival (PFS) -Duration of response (DOR) -Disease control rate (DCR) -Clinical benefit rate (CBR) -Overall survival (OS)-, Safety: Incidence and severity of AEs and clinical lab abnormalities. AE grades will be defined by the NCI-CTCAE v. 5.0. AE terms will be coded according to the MedDRA dictionary., Tolerabilidad: Incidencia de las modificaciones de dosis de tucatinib y vinorelbina, interrupciones debidas a AA, número de ciclos administrados, intensidad de dosis, etc, QoL: -Change from baseline (CFB) in the global health status score (GHS) and each scale of the EORTC QLQ-C30 questionnaire. -Time to deterioration (TTD) in QoL defined as the time from the date of enrollment to the date of first detection of a deterioration event (increase of ≥ minimally important difference (MID) from baseline for the EORTC QLQ-C30 symptom scales and a decrease of ≥ MID from baseline for the EORTC QLQ-C30 functional and GHS scales.

Source: https://euclinicaltrials.eu/ctis-public/view/2024-512590-27-00